EU clinical trial 2023-507321-42-00: A first-in-human, Phase 1, Dose Escalation Study of SGR-2921 as Monotherapy in subjects with relapsed/refractory Acute Myeloid Leukemia or Myelodysplastic Syndrome
Protocol code: SGR-2921-101
Sponsor: Schrodinger Inc. (Pharmaceutical company). Phase: Human Pharmacology (Phase I)- First administration to humans. Countries: Spain (ended), France (ended).
Therapeutic area(s): Diseases [C] - Hemic and Lymphatic Diseases [C15]
Gender: Female, Male. Age: 18-64 years, 65+ years. Enrolment: 53.
Status: Ended. Start date (EU): 2024-02-15. End date (EU): 2025-08-14. End date: 2025-08-15. Decision date: 2024-01-31. Results received: No. Last updated: 2025-05-12.
Decision dates by country: FR: 2024-03-19, ES: 2024-01-31

Condition(s): Myelodysplastic syndrome (MDS), Acute Myeloid Leukemia (AML)

Source: https://euclinicaltrials.eu/ctis-public/view/2023-507321-42-00